EU clinical trial 2023-503735-17-00: A Study About Fazirsiran in People With and Without Liver Problems.
Protocol code: TAK-999-1001
Sponsor: Takeda Development Center Americas Inc. (Pharmaceutical company). Phase: Human Pharmacology (Phase I)- Other. Countries: Hungary (ended), Slovakia (ended).
Therapeutic area(s): Not possible to specify
Gender: Female, Male. Age: 18-64 years, 65+ years. Enrolment: 41.
Status: Ended. Start date (EU): 2023-10-05. End date (EU): 2025-09-03. End date: 2025-09-04. Decision date: 2023-09-04. Results received: No. Last updated: 2025-05-09.
Decision dates by country: HU: 2023-09-07, SK: 2023-09-04

Condition(s): Hepatic impairment.

Source: https://euclinicaltrials.eu/ctis-public/view/2023-503735-17-00